EU clinical trial 2023-507891-31-00: A Phase 2, Open-label, Multicenter, Randomized Study to Evaluate the Persistence, Safety, and Acceptability of Twice Yearly Long-acting Subcutaneous Lenacapavir for HIV Pre-Exposure Prophylaxis (PrEP) in People Who Would Benefit from PrEP
Protocol code: GS-US-528-6727
Sponsor: Gilead Sciences Inc. (Pharmaceutical company). Phase: Phase II and Phase III (Integrated). Countries: France (ongoing, recruitment ended).
Therapeutic area(s): Diseases [C] - Virus Diseases [C02]
Gender: Female, Male. Age: 18-64 years, 65+ years. Enrolment: 112.
Status: Ongoing, recruitment ended. Start date (EU): 2024-10-11. Decision date: 2024-08-21. Results received: No. Last updated: 2026-04-14.
Decision dates by country: FR: 2024-09-16

Condition(s): Human Immunodeficiency Virus (HIV-1) infection
Product: TENOFOVIR DISOPROXIL AND EMTRICITABINE, Sunlenca 300 mg film-coated tablets, Sunlenca 464 mg solution for injection

Primary endpoint: On-time LEN injection at Day 1/baseline and Week 26 and on-time follow-up visit at Week 52, Dried blood spot (DBS) tenofovir diphosphate (TFV-DP) concentrations consistent with ≥ 4 doses/week (≥ 700 fmol/punch) at Weeks 13, 26, 39, and 52
Endpoint(s): Treatment-emergent adverse events and treatment emergent laboratory abnormalities, Questionnaire outcomes related to general acceptability of LEN and F/TDF, LEN plasma concentrations at Weeks 26 and 52

Source: https://euclinicaltrials.eu/ctis-public/view/2023-507891-31-00